EU clinical trial 2023-504201-36-00: LONG-TERM FOLLOW-UP PROTOCOL FOR SUBJECTS TREATED WITH GENE-MODIFIED T CELLS
Protocol code: GC-LTFU-001
Sponsor: Celgene Corp. (Pharmaceutical company). Phase: Phase II and Phase III (Integrated). Countries: Sweden (ongoing, recruiting), Finland (ongoing, recruiting), Netherlands (ongoing, recruiting), France (ongoing, recruiting), Spain (ongoing, recruiting), Norway (ongoing, recruiting), Austria (ongoing, recruiting), Italy (ongoing, recruiting), Belgium (ongoing, recruiting), Germany (ongoing, recruiting), Denmark (authorised, recruitment pending), Greece (authorised, recruitment pending), Romania (ongoing, recruiting), Poland (ongoing, recruiting), Czechia (authorised, recruitment pending), Hungary (authorised, recruitment pending), Portugal (authorised, recruitment pending).
Therapeutic area(s): Diseases [C] - Neoplasms [C04]; Diseases [C] - Immune System Diseases [C20]
Gender: Female, Male. Age: 0-17 years, 18-64 years, 65+ years. Enrolment: 367.
Start date (EU): 2018-12-21. Decision date: 2023-08-14. Results received: No. Last updated: 2026-07-27.
Decision dates by country: FI: 2023-08-14, DK: 2024-09-20, BE: 2023-09-25, CZ: 2025-10-27, NL: 2023-08-14, HU: 2025-10-31, SE: 2023-08-14, RO: 2024-07-29, FR: 2023-08-18, DE: 2023-10-12, ES: 2023-08-17, PT: 2025-09-16, NO: 2023-08-21, AT: 2023-09-11, PL: 2024-08-30, GR: 2024-09-20, IT: 2023-09-01

Condition(s): Defined by parent protocol. The study will enroll all adult and paediatric subjects who received at least one genetically modified T cells infusion in a previous Celgene sponsored study.
Product: HD Allogenic CD19-targeted CAR T, HD Allogenic CD19-targeted CAR T, Dual Targeting BCMAxGPRC5D CAR T, Dual Targeting BCMAxGPRC5D CAR T, HD Allogenic CD19-targeted CAR T, CD19-Targeted NEX-T CAR T, Dual Targeting BCMAxGPRC5D CAR T, Dual Targeting BCMAxGPRC5D CAR T, idecabtagene vicleucel, Dual Targeting BCMAxGPRC5D CAR T, HD Allogenic CD19-targeted CAR T, HD Allogenic CD19-targeted CAR T, GPRC5D-TARGETED CAR T, Lisocabtagene maraleucel

Primary endpoint: Safety endpoints:Incidence of delayed adverse events considered at least possiblyrelated to GM T cell therapy(incl. lymphodepleting chemotherapy) (i.e. neurologic/autoimmune/hematologic disorders, infections, hospitalizations, etc.)., Safety endpoints:Persistence of GM T-celldrug products, analysis of vector integration sites(Cohort 1), incidence of RCL(Cohort 1)., Safety endpoints:Pediatrics only: Physical growth as assessed by physical examination and sexual maturity., Efficacy endpoints:Overall survival (subjects with original diagnosis of malignancies), Efficacy endpoints:Proportion of subjects who progressed on the study (subjects with original diagnosis of malignancies), The timeframe for safety and efficacy assessments is up to 15 years from last GM T-cell infusion. For pediatric participants will continue until they reach Tanner Stage 5. Assessments will start 3 months after the last GM T-cell infusion, then will continue at a frequency of once every 6 months until Month 60, and then once a year until the EOS.
Endpoint(s): Lymphocyte count (B-cell) for participants that received a liso-celGM T-cell therapy(Cohort 1).This assessment will be required up to 5 years from the last GM T-cell infusion (with the same frequency described for the primary endpoints); otherwise follow up continues for up to 15 years.

Source: https://euclinicaltrials.eu/ctis-public/view/2023-504201-36-00